EU clinical trial 2023-503995-26-00: SERENA-4: A Randomised, Multicentre, Double-Blind, Phase 3 Study of AZD9833 (an Oral SERD) plus Palbociclib versus Anastrazole plus Palbociclib for the Treatment of Patients with Estrogen Receptor-Positive, HER2-Negative Advanced Breast Cancer Who Have Not Received Any Systemic Treatment for Advanced Disease
Protocol code: D8532C00001
Sponsor: AstraZeneca AB (Pharmaceutical company). Phase: Therapeutic confirmatory (Phase III). Countries: Slovakia (ongoing, recruitment ended), Spain (ongoing, recruitment ended), Austria (ongoing, recruitment ended), Czechia (ongoing, recruitment ended), Germany (ongoing, recruitment ended), France (ongoing, recruitment ended), Bulgaria (ongoing, recruitment ended), Norway (ongoing, recruitment ended), Italy (ongoing, recruitment ended), Belgium (ongoing, recruitment ended), Poland (ongoing, recruitment ended), Hungary (ongoing, recruitment ended), Portugal (ongoing, recruitment ended).
Therapeutic area(s): Diseases [C] - Neoplasms [C04]
Gender: Female, Male. Age: 18-64 years, 65+ years. Enrolment: 499.
Status: Ongoing, recruitment ended. Start date (EU): 2021-05-11. Decision date: 2024-03-13. Results received: No. Last updated: 2026-05-04.
Decision dates by country: NO: 2024-03-14, BE: 2024-03-22, CZ: 2024-03-13, DE: 2024-03-15, PL: 2024-03-25, ES: 2024-03-13, IT: 2024-03-25, AT: 2024-03-27, HU: 2024-03-18, BG: 2024-04-04, FR: 2024-03-15, SK: 2024-03-13, PT: 2024-03-13

Condition(s): Estrogen Receptor-Positive, HER2-Negative Advanced Breast Cancer
Product: camizestrant, Arimidex® 1 mg Filmtabletten, IBRANCE 75 mg hard capsules, Placebo to match camizestrant, Placebo to match Arimidex, LEUPRORELIN ACETATE, IBRANCE 125 mg hard capsules, IBRANCE 75 mg film-coated tablets, IBRANCE 100 mg hard capsules, IBRANCE 75 mg hard capsules, IBRANCE 100 mg hard capsules, IBRANCE 125 mg film-coated tablets, IBRANCE 100 mg film-coated tablets, IBRANCE 125 mg hard capsules, IBRANCE 100 mg hard capsules, Camizestrant, IBRANCE 125 mg hard capsules, IBRANCE 75 mg hard capsules, GOSERELIN ACETATE

Primary endpoint: Progression-free survival (PFS) assessed by the Investigator as defined by response evaluation criteria in solid tumors (RECIST) version 1.1.
Endpoint(s): "Overall survival (OS) ", Progression-free survival 2 (PFS2), "Objective response rate (ORR) assessed by the Investigator as defined by RECIST version 1.1 ", "Duration of response (DoR) assessed by the Investigator as defined by RECIST version 1.1 ", Time to second subsequent therapy (TSST), Time to chemotherapy (TTC), Time to first subsequent anti-cancer therapy (TFST), Clinical benefit rate at 24 weeks (CBR24), Plasma concentration of AZD9833 at specified timepoints, Change from baseline in EORTC QLQ-C30 and EORTC QLQ-BR45 scales

Source: https://euclinicaltrials.eu/ctis-public/view/2023-503995-26-00